EU clinical trial 2024-511868-83-00: Cyclophosphamide and Azathioprine vs Tacrolimus in antisynthetase syndrome-related interstitial lung disease : multicentric randomized phase III trial (CATR-PAT)
Protocol code: P140938J
Sponsor: Assistance Publique Hopitaux De Paris (Hospital/Clinic/Other health care facility). Phase: Therapeutic confirmatory (Phase III). Countries: France (ongoing, recruiting).
Therapeutic area(s): Diseases [C] - Respiratory Tract Diseases [C08]
Gender: Female, Male. Age: 18-64 years, 65+ years. Enrolment: 76.
Status: Ongoing, recruiting. Start date (EU): 2021-02-05. Decision date: 2024-09-17. Results received: No. Last updated: 2026-04-08.

Condition(s): Antisynthetase syndrome-related interstitial lung disease
Product: PROGRAF 5 mg, gélule, PROGRAF 1 mg, gélule, IMUREL 25 mg, comprimé pelliculé, CYCLOPHOSPHAMIDE, PROGRAF 0,5 mg, gélule

Primary endpoint: The composite primary endpoint is the time from the initiation of treatment to the first event related to ASS related ILD (progression free survival)
Endpoint(s): Global variation of the M0 and M12-six minute walk tests is compared (distance in meter, differential of saturation in %)., Global variation of M0 and M12-FVC and cDLCO is compared (both absolute and %), Lung improvement is defined (in the absence of any other pulmonary disease) by 3A. Improvement of at least 20% of the dyspnea visual scale score (1-10) 3B. and/or improvement of pulmonary function tests: increase of the baseline FVC by 10% (% patient predicted value or absolute value) or of the baseline cDLCO by 15% (% patient predicted value or absolute). 3C. and/or improvement of ILD on HRCT-scan (-5% involvement of the lung parench, Extra-pulmonary improvement is evaluated as follow: improvement of the muscle involvement, assessed by muscle manual testing at each visit, is defined by an increased score > 20%/ biological improvement of the muscle involvement, assessed by creatine kinase levels performed at every visit, is defined by a decreased of baseline creatin kinase > 50% (IU/ml)/improvement of the joint involvement, assessed by the ACR score at every visit is defined by a decrease > 20% of baseline, Extra-pulmonary improvement (muscle and joint involvements) is evaluated as follows: 5A. improvement of the muscle involvement, assessed by MMT/150 muscle testing at baseline and M12, is defined by an increased score > 20% 5B. improvement of the joint involvement, assessed by the ACR score at each visit is define by a decrease > 20% of baseline number of swelling and painful joints., Treatments tolerance (and efficacy) is recorded and compared as follows: any serious adverse event attributable to any experimental medication, which requires hospitalization, is recorded at any time. Side effects are declared by the patients, recorded and reported by the investigators at every visit. The number of patients switching of experimental treatment is recorded. The percentage of dose reduction of steroids and proportion of patients who require a dose increase at any time, The Quality of Life is assessed by the general questionnaire SF-36. Mean V1 (M0), V7 (M6) and V9 (M12) scores are compared.

Source: https://euclinicaltrials.eu/ctis-public/view/2024-511868-83-00